EU clinical trial 2023-505667-37-00: Sentinel node detection with 99Tc albumin nanocolloid and indocianine green (ICG) in patients with epithelial ovarian cancer in early stages. Pilot study.
Protocol code: MELISA II
Sponsor: Fundacio De Recerca Clinic Barcelona-Institut D’investigacions Biomediques August Pi I Sunyer (Laboratory/Research/Testing facility). Phase: Therapeutic exploratory (Phase II). Countries: Spain (ended).
Therapeutic area(s): Diseases [C] - Neoplasms [C04]; Diseases [C] - Female Urogenital Diseases and Pregnancy Complications [C13]
Gender: Female. Age: 18-64 years, 65+ years. Enrolment: 62.
Status: Ended. Start date (EU): 2023-10-06. End date (EU): 2026-04-21. Decision date: 2023-09-25. Results received: No. Last updated: 2024-06-24.

Condition(s): Epithelial ovarian cancer in early stages.
Product: Tekcis 2-50 GBq generador de radionucleido, ROTOP NanoHSA 500 microgramos equipo de reactivos para preparación radiofarmacéutica, Ultra-TechneKow FM 2,15-43,00 GBq generador de radionúclido

Primary endpoint: Global detection rate of sentinel lymph node in patients having received both tracers.
Endpoint(s): Diagnostic precision defined as global detection rate of sentinel lymph nodes and false negatives rate, stratified by morphologic characteristics, pathology results, FIGO stage, biochemistry results and surgical approach., Detection rate and false negative rate according to each tracer, stratified by morphologic characteristics, pathology results, FIGO stage, biochemistry results and surgical approach., Detection rate of sentinel lymph node with 99mTC in the group of patients having received the tracer., Detection rate and false negative rate according to each detection technique used, stratified by morphologic characteristics, pathology results, FIGO stage, biochemistry results and surgical approach., Anatomical location of sentinel lymph node according to each tracer and assessment of concordance between them., Pathology ultrastadification evaluation., Chirurgic and post-operative complications, directly or indirectly associated to the use of the tracers

Source: https://euclinicaltrials.eu/ctis-public/view/2023-505667-37-00